EU clinical trial 2024-517331-48-00: A Multi-Center, Double-Blind, Randomized, Phase III Study to Investigate the Efficacy and Safety of CS1003 in Combination with Lenvatinib Compared to Placebo in Combination with Lenvatinib as First-Line Therapy in Subjects with Advanced Hepatocellular Carcinoma (HCC)
Protocol code: CS1003-305
Sponsor: Cstone Pharmaceuticals (Suzhou) Co. Ltd. (Pharmaceutical company). Phase: Therapeutic confirmatory (Phase III). Countries: Poland (ended), Spain (ended).
Therapeutic area(s): Diseases [C] - Neoplasms [C04]
Gender: Female, Male. Age: 18-64 years, 65+ years. Enrolment: 74.
Status: Ended. Start date (EU): 2021-01-18. End date (EU): 2025-11-28. Decision date: 2024-10-29. Results received: No. Last updated: 2025-08-18.
Decision dates by country: ES: 2024-10-29, PL: 2024-10-31

Condition(s): Unresectable advanced hepatocellular carcinoma
Product: CS1003, Placebo, LENVATINIB

Primary endpoint: Overall survival
Endpoint(s): Objective response rate

Source: https://euclinicaltrials.eu/ctis-public/view/2024-517331-48-00